EU clinical trial 2024-512515-45-01: A Phase 1a/1b Open-Label Study Evaluating the Safety, Tolerability, Pharmacokinetics, and Efficacy of BBO-8520 in Subjects with Advanced KRASG12C Mutant Non-Small Cell Lung Cancer - The ONKORAS-101 Study
Protocol code: TBBO8520-101
Sponsor: Theras Inc. (Pharmaceutical company). Phase: Human Pharmacology (Phase I)- First administration to humans. Countries: Spain (ongoing, recruiting), Denmark (ongoing, recruiting).
Therapeutic area(s): Diseases [C] - Neoplasms [C04]
Gender: Female, Male. Age: 18-64 years, 65+ years. Enrolment: 45.
Status: Ongoing, recruiting. Start date (EU): 2026-04-10. Decision date: 2026-03-12. Results received: No. Last updated: 2026-06-23.
Decision dates by country: ES: 2026-03-20, DK: 2026-03-12

Condition(s): Non-Small Cell Lung Cancer

Source: https://euclinicaltrials.eu/ctis-public/view/2024-512515-45-01